EU clinical trial 2023-504664-42-02: REQUIRED DOSE OF CHOLECALCIFEROL IN THE MANAGEMENT OF VITAMIN D DEFICIENCY AND INSUFFICIENCY IN POSTMENOPAUSAL WOMEN
Protocol code: IP-VITD
Sponsor: Clinica Palacios Madrid S.L. (Hospital/Clinic/Other health care facility). Phase: Therapeutic confirmatory (Phase III). Countries: Spain (ongoing, recruiting).
Therapeutic area(s): Diseases [C] - Nutritional and Metabolic Diseases [C18]
Gender: Female. Age: 18-64 years, 65+ years. Enrolment: 80.
Status: Ongoing, recruiting. Start date (EU): 2023-07-03. Decision date: 2023-06-27. Results received: No. Last updated: 2023-06-27.

Condition(s): POSTMENOPAUSAL WOMEN
Product: Lundeos 20.000 UI cápsulas blandas

Primary endpoint: To evaluate the efficacy of cholecalciferol, serum vitamin D titration will be performed at the initial view, view 3 and final visit.
Endpoint(s): Vitamin D levels will be evaluated in the four groups to see if with 1000 IU normal levels are maintained. The patients' satisfaction with the treatment will be evaluated.

Source: https://euclinicaltrials.eu/ctis-public/view/2023-504664-42-02